EU clinical trial 2024-515253-25-00: A Phase I/II clinical trial of hematopoietic stem cell gene therapy for the treatment of Metachromatic Leukodystrophy
Protocol code: 201222
Sponsor: Orchard Therapeutics (Europe) Limited (Pharmaceutical company). Phase: Phase I and Phase II (Integrated)- Other. Countries: Italy (ended).
Therapeutic area(s): Phenomena and Processes [G] - Genetic Phenomena [G05]
Gender: Female, Male. Age: 0-17 years. Enrolment: 20.
Status: Ended. Start date (EU): 2010-04-08. End date (EU): 2025-09-19. End date: 2025-09-20. Decision date: 2024-10-01. Results received: Yes. Last updated: 2025-07-23.

Condition(s): Metachromatic Leukodystrophy (MLD)
Product: Libmeldy 2-10 x 10^6 cells/mL dispersion for infusion

Primary endpoint: Safety endpoint- 1. Conditioning regimen-related safety, consisting of the absence of engraftment failure or delayed hematological reconstitution (prolonged aplasia) and surveillance of non-hematological regimen related toxicity (AEs with NCI Common Toxicity Criteria grade ≥ 2; and laboratory parameters with NCI Common Toxicity Criteria grade ≥ 3)., 2. Safety of LV-transduced cell infusion, defined as: a) short-term safety and tolerability of lentiviraltransduced cell infusion; b) long-term safety of lentiviral-transduced cell infusion (absence of Replication Competent Lentivirus (RCL) and abnormal clonal proliferation)., Efficacy endpoints- 1. An improvement of ≥ 10% of the total score at gross motor function measure (GMFM) at comparison with the GMFM scores obtained by aged matched untreated MLD patients, evaluated 24 months after treatment. 2. A significant increase of Arylsulfatase A (ARSA) activity as compared to pre-treatment values, measured in total peripheral blood mononuclear cells 24 months after treatment
Endpoint(s): Safety endpoint- 1. Absence of immune responses against the transgene, Efficacy Endpoints- o The Nerve Conduction Velocity Index at 24 months after treatment compared to scores observed in the historical control MLD population. Nerve conduction velocity in individual sensory and motor nerves will also be evaluated. o The total brain MRI scores at 24 months after treatment compared to scores observed in the historical control MLD population. o GMFC-MLD levels at different ages in treated subjects compared to the historical control MLD population, o The measurement of Intelligence Quotient (IQ) values above 55 at 24, 30 and 36 months after treatment. o An engraftment of the transduced cells above 4% in bone marrowderived clonogenic progenitor cells at 12 months after the transplant. o Vector copy number (VCN) per cell in total PBMC, total BM, and peripheral blood (PB) and BM cell subpopulations will also be evaluated. o Evaluation of correlations occurring between transduced cell engraftment levels and busulfan exposure.

Source: https://euclinicaltrials.eu/ctis-public/view/2024-515253-25-00